EU clinical trial 2023-509515-89-00: Safety and immune responses after vaccination with two investigational RNA-based vaccines against tuberculosis in healthy volunteers
Protocol code: BNT164-01
Sponsor: BioNTech SE (Pharmaceutical company). Phase: Human Pharmacology (Phase I)- First administration to humans. Countries: Germany (ended).
Therapeutic area(s): Diseases [C] - Bacterial Infections and Mycoses [C01]
Gender: Female, Male. Age: 18-64 years. Enrolment: 128.
Status: Ended. Start date (EU): 2023-04-14. End date (EU): 2025-12-08. Decision date: 2024-03-13. Results received: No. Last updated: 2025-07-17.

Condition(s): Tuberculosis

Source: https://euclinicaltrials.eu/ctis-public/view/2023-509515-89-00